EU clinical trial 2024-511596-15-00: A Dose-Finding, Double-Blind, Placebo-Controlled Phase 2 Study to Evaluate the Efficacy and Safety of GSK4532990 for Steatohepatitis in Adults with Alcohol-related Liver Disease (ALD)
Protocol code: 222291
Sponsor: Glaxosmithkline Research & Development Limited (Pharmaceutical company). Phase: Therapeutic exploratory (Phase II). Countries: Denmark (ongoing, recruiting), Germany (ongoing, recruiting), Sweden (ongoing, recruiting), France (ongoing, recruiting), Spain (ongoing, recruiting), Italy (ongoing, recruiting), Greece (ongoing, recruiting), Poland (ongoing, recruiting).
Therapeutic area(s): Diseases [C] - Nutritional and Metabolic Diseases [C18]
Gender: Female, Male. Age: 18-64 years, 65+ years. Enrolment: 147.
Status: Ongoing, recruiting. Start date (EU): 2024-12-26. Decision date: 2024-10-21. Results received: No. Last updated: 2026-08-03.
Decision dates by country: GR: 2026-01-14, FR: 2024-10-21, DK: 2024-10-21, PL: 2026-01-30, IT: 2024-12-19, ES: 2024-10-22, SE: 2024-10-24, DE: 2024-10-22

Condition(s): Liver Diseases, Alcoholic

Primary endpoint: Change from baseline in LSM using FibroScan® at Week 52, considering death, liver-related hospitalization, liver transplantation and HCC to be poor outcomes, Change from baseline in MELD score at Week 52, considering death, liver-related hospitalization, liver transplantation and HCC to be poor outcomes
Endpoint(s): Change from baseline in serum AST at Week 52, considering death, liver-related hospitalization, liver transplantation and HCC to be poor outcomes, Plasma exposure parameters of GSK4532990 including: • Area under the concentration-time curve from time zero (pre-dose) to the last quantifiable concentration (AUC0-t) • Maximum observed concentration (Cmax), Change from baseline in ELF at Week 52, considering death, liver-related hospitalization, liver transplantation and HCC to be poor outcomes

Source: https://euclinicaltrials.eu/ctis-public/view/2024-511596-15-00